EU clinical trial 2025-520658-12-00: A double-blind, randomised, placebo-controlled, parallel group, Phase IIa trial to evaluate safety, tolerability, pharmacokinetics, pharmacodynamics, and efficacy of BI 765423 administered intravenously with or without standard of care in patients with idiopathic pulmonary fibrosis
Protocol code: 1493-0002
Sponsor: Boehringer Ingelheim International GmbH, Boehringer Ingelheim Espana S.A. (Pharmaceutical company). Phase: Therapeutic exploratory (Phase II). Countries: Germany (ongoing, recruiting), Italy (ongoing, recruiting), Spain (ongoing, recruiting), Belgium (ongoing, recruiting).
Therapeutic area(s): Diseases [C] - Respiratory Tract Diseases [C08]
Gender: Female, Male. Age: 18-64 years, 65+ years. Enrolment: 18.
Status: Ongoing, recruiting. Start date (EU): 2025-11-20. Decision date: 2025-10-09. Results received: No. Last updated: 2026-07-20.
Decision dates by country: ES: 2025-10-20, DE: 2025-10-24, BE: 2025-10-09, IT: 2025-10-16

Condition(s): Idiopathic Pulmonary Fibrosis (IPF)
Product: Placebo to BI 765423, BI 765423

Primary endpoint: Absolute change from baseline in FVC (mL) at 12 weeks
Endpoint(s): Absolute change from baseline in log10-transformed SP-D plasma concentration at 12 weeks., Absolute change from baseline in distance walked (m) during 6 meter walking test (6MWT) at 12 weeks., Absolute change from baseline in FVC % predicted at 12 weeks., Absolute change from baseline in DLCO % predicted at 12 weeks., Absolute change from baseline in oxygen saturation (SpO2) on room air at rest at 12 weeks., Absolute change from baseline in FVC (mL) at 24 weeks, Absolute change from baseline in DLCO % predicted at 24 weeks, Absolute change from baseline in distance walked (m) during 6MWT at 24 weeks

Source: https://euclinicaltrials.eu/ctis-public/view/2025-520658-12-00